EU clinical trial 2025-522107-18-00: A Phase 2, Open-label, Multicohort, Study of Rinatabart Sesutecan (Rina-S) in Participants with Non-Small Cell Lung Cancer
Protocol code: GCT1184-05
Sponsor: Genmab A/S (Pharmaceutical company). Phase: Therapeutic exploratory (Phase II). Countries: Germany (ongoing, recruiting), Hungary (authorised, recruiting), Netherlands (ongoing, recruiting), France (ongoing, recruiting), Italy (ongoing, recruiting), Belgium (ongoing, recruiting), Spain (ongoing, recruiting), Poland (ongoing, recruiting).
Therapeutic area(s): Diseases [C] - Neoplasms [C04]
Gender: Female, Male. Age: 18-64 years, 65+ years. Enrolment: 112.
Start date (EU): 2026-05-19. Decision date: 2026-04-14. Results received: No. Last updated: 2026-07-16.
Decision dates by country: HU: 2026-04-20, PL: 2026-04-20, BE: 2026-06-01, DE: 2026-04-15, FR: 2026-04-16, NL: 2026-04-14, IT: 2026-04-15, ES: 2026-06-02

Condition(s): Locally advanced or metastatic Non-Small Cell Lung Cancer
Product: PEGFILGRASTIM, Rinatabart Sesutecan

Primary endpoint: Objective Response Rate (ORR) per Response Evaluation Criteria in Solid Tumors (RECIST) v1.1 as Assessed by Investigator [Time Frame: Approximately 3 years]
Endpoint(s): 1.Duration of Response (DOR) per RECIST v1.1 as Assessed by Investigator [Time Frame: Approximately 4 years], 2.Disease Control Rate (DCR) per RECIST v1.1 as Assessed by Investigator [Time Frame: Approximately 4 years], 3.Progression-free Survival (PFS) [Time Frame: Approximately 4 years], 4.Overall Survival (OS) [Time Frame: Approximately 4 years], 5.Maximum (Peak) Observed Serum Drug Concentration (Cmax) of Rina-S Related Analytes [Time Frame: Approximately 12 months], 6.Time to Reach Maximum (Peak) Serum Drug Concentration (Tmax) of Rina-S Related Analytes[Time Frame: Approximately 12 months], 7.Number of Participants with Antidrug Antibodies (ADAs) [Time Frame: Approximately 12 months], 8.Number of Participants with Treatment-emergent Adverse Events (TEAEs) [Time Frame: Approximately 4 years]

Source: https://euclinicaltrials.eu/ctis-public/view/2025-522107-18-00